EU clinical trial 2025-523275-27-00: HELIOS: An Open-Label, Long-Term Study to Investigate the Safety, Tolerability, and Efficacy of DISC-1459 (Bitopertin) in Participants with Erythropoietic Protoporphyria (EPP) or X-Linked Protoporphyria (XLP).
Protocol code: DISC-1459-501
Sponsor: Disc Medicine Inc. (Pharmaceutical company). Phase: Therapeutic confirmatory (Phase III). Countries: Italy (authorised, recruitment pending), France (ongoing, recruiting), Ireland (authorised, recruitment pending), Belgium (authorised, recruiting), Sweden (authorised, recruitment pending), Germany (ongoing, recruiting), Netherlands (ongoing, recruiting), Norway (ended), Spain (ongoing, recruiting).
Therapeutic area(s): Diseases [C] - Nutritional and Metabolic Diseases [C18]
Gender: Female, Male. Age: 0-17 years, 18-64 years, 65+ years. Enrolment: 49.
Start date (EU): 2026-05-26. Decision date: 2026-02-12. Results received: No. Last updated: 2026-07-14.
Decision dates by country: SE: 2026-02-16, IT: 2026-02-16, NO: 2026-02-16, ES: 2026-02-18, DE: 2026-02-12, IE: 2026-02-20, NL: 2026-02-13, FR: 2026-02-12, BE: 2026-02-13

Condition(s): Erythropoietic Protoporphyria (EPP), X-Linked Protoporphyria (XLP)
Product: Bitopertin

Primary endpoint: Safety and tolerability of bitopertin, as assessed by the incidence of treatmentemergent adverse events (TEAEs), vital signs, physical examinations, and clinical laboratory parameters.
Endpoint(s): 1. Change from baseline in daylight tolerance, as assessed by total hours spent in sunlight without pain and average time to first prodromal syndrome in sunlight., 2. Percent change from baseline in whole blood metal-free PPIX concentrations., 3. Plasma bitopertin concentrations.

Source: https://euclinicaltrials.eu/ctis-public/view/2025-523275-27-00